EU clinical trial 2023-509321-50-00: TIME AND MOTION STUDY OF A SUBCUTANEOUS FIXED DOSE COMBINATION OF PERTUZUMAB AND TRASTUZUMAB FOR THE TREATMENT OF PATIENTS WITH HER2-POSITIVE EARLY BREAST CANCER (PHATIMA)
Protocol code: ML42502
Sponsor: Roche Farma S.A. (Pharmaceutical company). Phase: Therapeutic confirmatory (Phase III). Countries: Spain (ended).
Therapeutic area(s): Diseases [C] - Neoplasms [C04]
Gender: Female, Male. Age: 18-64 years, 65+ years. Enrolment: 34.
Start date (EU): 2021-04-15. Decision date: 2024-01-11. Results received: Yes. Last updated: 2025-02-14.

Condition(s): HER2-POSITIVE EARLY BREAST CANCER
Product: Phesgo 1200 mg/600 mg solution for injection, Perjeta 420 mg concentrate for solution for infusion, Herceptin 600 mg solution for injection in vial, Phesgo 600 mg/600 mg solution for injection, Herceptin 150 mg powder for concentrate for solution for infusion

Primary endpoint: Average HCP time per patient per visit (per treatment cycle), measured for cycles 2-7 in the adjuvant setting, for the different administration route processes, time disaggregated per pre-specified task as well as per HCP (oncologist, nurse pharmacist and other): IV administration route process and SC administration route process include such tasks as: preparation times and administration times, Average patient time per visit (per treatment cycle), measured for cycles 2-7 in the adjuvant setting, for the different administration route processes: patient chair time (measured as time between sitting and rising from infusion chair) and treatment room time (measured as time between entrance and exit from the treatment room)
Endpoint(s): Average patient hospital time per visit (per treatment cycle), measured for cycles 2-7 in the adjuvant setting, for the different administration route processes measured as time between first entry and last exit from the hospital for their adjuvant treatment, Average quantity for each consumable used per patient visit (per treatment cycle), measured for cycles 2-7 in the adjuvant setting, per pre-specified task for the different administration route processes. Milligrams wasted from partly-used vials per patient visit (per treatment cycle), measured for cycles 2-7 in the adjuvant setting, To describe the safety and tolerability of PH FDC SC, P IV + H IV and P IV + H SC based on the following endpoints: o Incidence, nature and severity of all AEs, ≥ Grade 3 AEs, SAEs and cardiac AEs (including left ventricular ejection fraction [LVEF] events). o Incidence of premature withdrawal from study treatment. o Targeted vital signs and physical findings. o Targeted clinical laboratory test results.

Source: https://euclinicaltrials.eu/ctis-public/view/2023-509321-50-00